EU clinical trial 2022-500823-61-00: A Phase 1/2 Study of BMS-986408 Alone and in Combination with Nivolumab or with Nivolumab and Ipilimumab in Participants with Advanced Solid Tumors
Protocol code: CA099-003
Sponsor: Bristol-Myers Squibb International Corporation (Pharmaceutical company). Phase: Phase I and Phase II (Integrated)- First administration to humans. Countries: France (ended), Spain (ended).
Therapeutic area(s): Diseases [C] - Neoplasms [C04]
Gender: Female, Male. Age: 18-64 years, 65+ years. Enrolment: 34.
Status: Ended. Start date (EU): 2024-04-08. End date (EU): 2025-07-24. End date: 2025-07-25. Decision date: 2023-05-24. Results received: Yes. Last updated: 2025-01-08.
Decision dates by country: ES: 2023-05-24, FR: 2023-08-01

Condition(s): Advanced Solid Tumours
Product: OPDIVO 10 mg/mL concentrate for solution for infusion., Ipilimumab, DGKα/ζ Inhibitor, DGKα/ζ Inhibitor, OPDIVO 10 mg/mL concentrate for solution for infusion., DGKα/ζ Inhibitor

Primary endpoint: Incidence of DLTs, AEs, SAEs, AEs leading to discontinuation, and deaths.
Endpoint(s): Summary measures of BMS-986408 PK parameters in plasma, such as, but not limited to, Cmax, Tmax, and AUC (0-T), from concentration-time data during BMS-986408 monotherapy and in combination with nivolumab or nivolumab and ipilimumab., ORR and DOR per RECIST v1.1.

Source: https://euclinicaltrials.eu/ctis-public/view/2022-500823-61-00